EU clinical trial 2023-509619-10-00: Single cell characterization of persistent cells upon treatment with durvalumab (MEDI4736) with or without tremelimumab in MSS and MSI colorectal and endometrial tumors: the SERPENTINE clinical trial (Single cEll pRofiling PErsistaNce To ImmuNothErapy)
Protocol code: ESR 21-21165
Sponsor: Vall D Hebron Institute Of Oncology (Laboratory/Research/Testing facility). Phase: Therapeutic exploratory (Phase II). Countries: Spain (ongoing, recruitment ended).
Therapeutic area(s): Diseases [C] - Neoplasms [C04]
Gender: Female, Male. Age: 18-64 years, 65+ years. Enrolment: 60.
Status: Ongoing, recruitment ended. Start date (EU): 2024-08-29. Decision date: 2024-10-14. Results received: No. Last updated: 2025-12-12.

Condition(s): MSS and MSI colorectal and endometrial tumors
Product: TREMELIMUMAB, DURVALUMAB

Primary endpoint: Objective response rate (ORR) according to Response Evaluation Criteria in Solid Tumors (RECIST) v1.1, and iRECIST if applicable, in patients with advanced, immune naïve MSS CRC, MSS EC, MSI CRC and MSI EC.
Endpoint(s): • To assess the antitumor activity of durvalumab and durvalumab + tremelimumab in MSS CRC/EC and MSI CRC/EC based on additional measures: o Duration of response (DoR), Progression free survival (PFS), Overall survival (OS), Time to maximum response (TTMR), Immune-related (ir) response rate (irRR), • To assess the safety of durvalumab and durvalumab + tremelimumab in the cohort of patients included in the trial., • Characterize at a single cell resolution the transcriptome of the tumors at baseline and upon treatment with immunotherapy, including at the time of maximal response, and at progression., • To correlate the antitumor activity of durvalumab and durvalumab + tremelimumab with other biomarkers on tumor tissue and in blood samples., The endpoints for biomarkers assessment on tumor tissue and peripherical blood will include: Genomic and immune biomarkers, The endpoints for assessment the safety of durvalumab and tremelimumab will include the rate of adverse events (AEs) and serious adverse events (SAEs).

Source: https://euclinicaltrials.eu/ctis-public/view/2023-509619-10-00